EU clinical trial 2025-522631-34-00: J2A-MC-GZPT A Phase 3 Study to Investigate the Efficacy and Safety of Orfor-glipron Once Daily in Participants Who Have Obesity or Overweight and Osteoar-thritis of the Knee: A Multicenter, Randomized, Double-Blind, Parallel-Arm, Pla-cebo-Controlled Trial List of Intervention-Specific Appendices (ISAs): ISA1 (GZT1): A Study to Investigate Efficacy and Safety of Orforglipron Once Daily in Participants Who Have Obesity or Overweight and Osteoarthritis of the Knee ISA2 (GZT2): A Study to Investigate Efficacy and Safety of Orforglipron Once Daily in Participants Who Have Obesity or Overweight and Osteoarthritis of the Knee
Protocol code: J2A-MC-GZPT
Sponsor: Eli Lilly & Co. (Pharmaceutical company). Phase: Therapeutic confirmatory (Phase III). Countries: Germany (ongoing, recruiting), Spain (ongoing, recruiting).
Therapeutic area(s): Diseases [C] - Musculoskeletal Diseases [C05]
Gender: Female, Male. Age: 18-64 years, 65+ years. Enrolment: 180.
Status: Ongoing, recruiting. Start date (EU): 2026-01-14. Decision date: 2025-12-29. Results received: No. Last updated: 2026-08-04.
Decision dates by country: ES: 2026-01-11, DE: 2025-12-29

Condition(s): Osteoarthritis
Product: Orforglipron, Orforglipron, Placebo to match LY, Orforglipron, Orforglipron, Orforglipron, Orforglipron

Primary endpoint: Change from Baseline in the Western Ontario and McMaster Universities Osteoarthritis Index (WOMAC) Pain Subscale Score

Source: https://euclinicaltrials.eu/ctis-public/view/2025-522631-34-00